EU clinical trial 2024-518533-29-00: Evaluation of the safety and efficacy of an advanced therapy medicinal product containing live ASCs in the treatment of diabetic foot syndrome – a double-blind, randomized study.
Protocol code: FOOTCELL
Sponsor: Medical University Of Warsaw (Educational Institution). Phase: Therapeutic exploratory (Phase II). Countries: Poland (ongoing, recruiting).
Therapeutic area(s): Diseases [C] - Nutritional and Metabolic Diseases [C18]
Gender: Female, Male. Age: 18-64 years, 65+ years. Enrolment: 105.
Status: Ongoing, recruiting. Start date (EU): 2025-03-05. Decision date: 2024-12-16. Results received: No. Last updated: 2026-04-13.

Condition(s): DIABETIC FOOT ULCER
Product: Ringer Lactate

Primary endpoint: Change in wound surface area, Type, frequency, and severity of adverse events, Changes in laboratory tests and vital parameters Assessment time point: at the end of the active treatment phase (6 weeks after the first administration of ADSC/ASC)
Endpoint(s): Total percentage of patients with significant clinical success defined as achieving a specified degree of wound epithelialization: *Complete wound closure (100% epithelialization), or *Partial wound epithelialization (>50% epithelialization), Parameters for assessing clinical efficacy: *Change in wound surface area over time measured from the first administration of the treatment under investigation *Percentage of patients with significant clinical success over time assessed as complete wound closure (100% epithelialization), or partial wound epithelialization (>50% epithelialization), Dynamics of wound healing assessed as: *Time to achieve a 50% reduction in wound surface area *Time to achieve the greatest reduction in wound surface area *Time to achieve complete wound closure (100% epithelialization), Absolute change in pain perception over time assessed using the Visual Analogue Scale (VAS)., The need for antibiotic therapy due to wound infection *Number of patients *Number of antibiotic therapies *Assessment time points: at the end of the active treatment phase (6 weeks after the first administration of ADSC/ASC) and at the end of the study, Change in quality of life parameters according to the EQ-5D-5L questionnaire Assessment time points: at the end of the active treatment phase (6 weeks after the first administration of ADSC/ASC) and at the end of the study

Source: https://euclinicaltrials.eu/ctis-public/view/2024-518533-29-00